EU clinical trial 2024-514353-30-00: METRO Early discontinuation of steroid treatment in negative FDG-PET/CT patients with idiopathic retroperitoneal fibrosis. A prospective multicentric study
Sponsor: Assistance Publique Hopitaux De Paris (Hospital/Clinic/Other health care facility). Phase: Therapeutic use (Phase IV). Countries: France (ongoing, recruiting).
Therapeutic area(s): Diseases [C] - Immune System Diseases [C20]
Gender: Female, Male. Age: 18-64 years, 65+ years. Enrolment: 41.
Status: Ongoing, recruiting. Start date (EU): 2022-11-25. Decision date: 2024-07-30. Results received: No. Last updated: 2025-09-29.

Condition(s): Idiopathic retroperitoneal fibrosis
Product: PREDNISONE

Primary endpoint: The primary endpoint is the cumulate IRF relapse rate measured at the end of the study (M21). The diagnosis of IRF relapse is based on the association of a clinical or biological criterion with a radiological criterion (i.e. composite criteria):
Endpoint(s): 1. a. Visual grades of retroperitoneal fibrosis FDG uptake as compared to liver FDG uptake (which consist of one item that yields a score of 0 to III), maximal standardized uptake value (SUVmax) within the retroperitoneal fibrosis (regions of interest- ROI) at diagnosis (M0), remission (M9), M21 and relapse, b. Metabolic volume (i.e. ratio of metabolically active volume (MAV) to global lesion volume) of retroperitoneal fibrosis FDG uptake at diagnosis (M0), remission (M9), M21 and relapse,, 2. Diagnostic performance of SUVmax and MAV (area under the curve (AUC) and performance values for the Youden index) for the disease activity,, 3. Frequency of diabetes, severe infection, osteoporotic fracture and major cardiovascular events 12 months after remission (M21). Serious cardiovascular adverse events are defined as a composite of nonfatal stroke, nonfatal myocardial infarction, and cardiovascular death and will be assessed at M12,M15 and M21

Source: https://euclinicaltrials.eu/ctis-public/view/2024-514353-30-00